EU clinical trial 2023-505023-31-00: A Multicenter, Double-blind, Randomized Phase 3 Study to Compare the Efficacy and Safety of Belzutifan (MK-6482) Plus Pembrolizumab (MK-3475) Versus Placebo Plus Pembrolizumab, in the Adjuvant Treatment of Clear Cell Renal Cell Carcinoma (ccRCC) Post Nephrectomy (MK-6482-022)
Protocol code: MK-6482-022
Sponsor: Merck Sharp & Dohme LLC (Pharmaceutical company). Phase: Therapeutic confirmatory (Phase III). Countries: Hungary (ongoing, recruitment ended), Finland (ongoing, recruitment ended), Sweden (ongoing, recruitment ended), Netherlands (ongoing, recruitment ended), Ireland (ongoing, recruitment ended), Spain (ongoing, recruitment ended), France (ongoing, recruitment ended), Romania (ongoing, recruitment ended), Bulgaria (ongoing, recruitment ended), Germany (ongoing, recruitment ended), Czechia (ongoing, recruitment ended), Italy (ongoing, recruitment ended), Greece (ongoing, recruitment ended), Poland (ongoing, recruitment ended).
Therapeutic area(s): Diseases [C] - Neoplasms [C04]
Gender: Female, Male. Age: 18-64 years, 65+ years. Enrolment: 549.
Status: Ongoing, recruitment ended. Start date (EU): 2023-11-17. Decision date: 2023-10-31. Results received: No. Last updated: 2026-05-22.
Decision dates by country: HU: 2023-11-02, NL: 2023-11-06, FI: 2023-11-02, IE: 2023-11-06, CZ: 2023-11-16, ES: 2023-10-31, PL: 2023-12-07, SE: 2023-10-31, RO: 2023-11-07, IT: 2023-11-24, BG: 2023-11-15, FR: 2023-11-02, GR: 2023-12-18, DE: 2023-11-17

Condition(s): Renal cell carcinoma
Product: Placebo for MK6482, KEYTRUDA 25 mg/mL concentrate for solution for infusion, Belzutifan

Primary endpoint: Disease-Free Survival (DFS)
Endpoint(s): Overall Survival (OS), Number of Participants Who Experience At Least One Adverse event (AE), Number of Participants Who Discontinue Study Treatment Due to an AE, Disease Recurrence-Specific Survival 1 (DRSS1), Disease Recurrence-Specific Survival 2 (DRSS2), Change From Baseline in Health-Related Quality-of-Life (HRQoL) Using the European Organization for Research and Treatment of Cancer Quality of Life Questionnaire Core 30 (EORTC QLQ-C30) Items 29 and 30 Score, Change From Baseline in Physical Functioning Using the EORTC QLQ-C30 Items 1- 5 Score, Change From Baseline in Role Functioning Using the EORTC QLQ-C30 Items 6 and 7 Score, Change From Baseline in Disease Symptoms Using the Functional Assessment of Cancer Therapy-Kidney Symptom Index-Disease-related Symptoms (FKSI-DRS) Items 1-9 Score

Source: https://euclinicaltrials.eu/ctis-public/view/2023-505023-31-00